EU clinical trial 2024-517920-21-00: A prospective, double-blinded, randomized, placebo-controlled phase 1/2a study to assess safety, tolerability, systemic exposure and preliminary efficacy of single intraarticular injections of three dose levels of SYN321 and placebo in patients with symptomatic knee osteoarthritis
Protocol code: SYN321-01
Sponsor: Synartro AB (Pharmaceutical company). Phase: Phase I and Phase II (Integrated)- Other. Countries: Sweden (ended).
Therapeutic area(s): Diseases [C] - Musculoskeletal Diseases [C05]
Gender: Female, Male. Age: 18-64 years, 65+ years. Enrolment: 36.
Status: Ended. Start date (EU): 2025-08-19. End date (EU): 2026-02-02. Decision date: 2024-10-08. Results received: No. Last updated: 2025-11-17.

Condition(s): knee osteoarthritis
Product: Natriumklorid Braun 9 mg/ml spädningsvätska för parenteral användning

Primary endpoint: Frequency, seriousness, and intensity of AEs., Clinically significant changes in electrocardiogram (ECG), vital signs, safety laboratory measurements (hematology, clinical chemistry, coagulation), physical examination findings and local tolerability.
Endpoint(s): Concentration of diclofenac, linker (and linker associated metabolites) and diclofenac lactam in plasma and urine. Concentrations in urine will be assessed in an exploratory manner. The following pharmacokinetic (PK) parameters will be explored: maximum plasma concentration (Cmax) and area under the plasma concentration vs. time curve (AUC) Additional PK parameters may be explored if deemed appropriate., Self-registered pain using the NRS (0-10) once daily every day until Day 56. NRS sum of pain intensity difference (SPID) for current pain in the index knee will be analyzed for all time points measured., Self-registered function and quality of life using Knee Injury and Osteoarthritis Outcome Score (KOOS). Change from baseline in average sum of KOOS scores, KOOS subscale scores., Use of rescue medication.

Source: https://euclinicaltrials.eu/ctis-public/view/2024-517920-21-00